EU clinical trial 2023-509111-89-00: The use of dupilumab in treatment of indolent systemic mastocytosis with skin involvement
Protocol code: NBK231/1/2023
Sponsor: Medical University Of Gdansk (Educational Institution). Phase: Therapeutic confirmatory (Phase III). Countries: Poland (ongoing, recruiting).
Therapeutic area(s): Diseases [C] - Skin and Connective Tissue Diseases [C17]; Diseases [C] - Immune System Diseases [C20]
Gender: Female, Male. Age: 18-64 years, 65+ years. Enrolment: 66.
Status: Ongoing, recruiting. Start date (EU): 2025-10-15. Decision date: 2025-03-10. Results received: No. Last updated: 2025-06-30.

Condition(s): Systemic mastocytosis with a slow course and involvement of the skin
Product: Telfexo 180 mg, tabletki powlekane, Injectio Natrii Chlorati Isotonica Polpharma, 9 mg/ml, rozpuszczalnik do sporządzania leków parenteralnych, PL2 - placebo for Telfexo 180 mg, Dupixent 300 mg solution for injection in pre-filled syringe

Primary endpoint: 1. Reducing the incidence of symptoms caused by the release of mast cell mediators, mainly anaphylaxis (number of anaphylaxis and flushing/week) 2. Reducing the extent of skin lesions (BSA-Body Surface Area assessed according to the principle Nines Wallace) 3. Reduction of itch severity (VAS) 4. Improving the quality of life (MC-QoL, EORTC QLQ C30) 5. Reducing symptoms of depression (Hamilton Rating Scale for Depression) and fatigue (Fatigue Impact Scale)
Endpoint(s): 1. Quality of Life in Mastocytosis (QLMS) Questionnaire, 2. The incidence of life-threatening anaphylactic reactions, 3. Decreased concentration of tryptase, IL4 and IL13 in peripheral blood serum.

Source: https://euclinicaltrials.eu/ctis-public/view/2023-509111-89-00